EU clinical trial 2023-506512-40-00: Effect of low-dose arginine-vasopressin supplementation on post-transplant Acute Kidney Injury after liver transplantation - AVENIR Trial
Protocol code: APHP220827
Sponsor: Assistance Publique Hopitaux De Paris (Hospital/Clinic/Other health care facility). Phase: Therapeutic confirmatory (Phase III). Countries: France (ongoing, recruiting).
Therapeutic area(s): Diseases [C] - Female Urogenital Diseases and Pregnancy Complications [C13]; Diseases [C] - Digestive System Diseases [C06]; Diseases [C] - Male Urogenital Diseases [C12]
Gender: Female, Male. Age: 18-64 years, 65+ years. Enrolment: 304.
Status: Ongoing, recruiting. Start date (EU): 2025-04-16. Decision date: 2024-01-12. Results received: No. Last updated: 2026-05-19.

Condition(s): Acute Kidney Injury, Liver transplantation
Product: REVERPLEG 40 U.I./2 mL, solution à diluer pour perfusion, NORADRENALINE VIATRIS 2 mg/ml SANS SULFITES, solution à diluer pour perfusion

Primary endpoint: Stages of AKI according to AKI Network criteria (KDIGO score) during the first 7 postoperative days
Endpoint(s): The number of packed red blood cells and fresh frozen plasma transfused intraoperatively and during the first 12 hours postoperatively, The need for renal replacement for replacement therapy (RRT) in ICU, Average intraoperative norepinephrine concentrations, Average intraoperative concentrations of other vasopressors and inotropes (Adrenalin, Dobutamine), Number of platelets transfused intraoperatively and during the first 12 hours postoperatively, Amount of vascular filling solutions intraoperatively and during the first 12 hours postoperatively, Sequential Organ Failure Assessment (score SOFA) on the third postoperative day, Number of days alive outside intensive care unit during the 30 day post-operation, Mortality at 30 days

Source: https://euclinicaltrials.eu/ctis-public/view/2023-506512-40-00